EU clinical trial 2024-512005-87-00: A Phase II, two-arm study to investigate tepotinib combined with osimertinib in MET amplified, advanced or metastatic non-small cell lung cancer (NSCLC) harboring activating EGFR mutations and having acquired resistance to prior osimertinib therapy (INSIGHT 2 Study)
Protocol code: MS200095-0031
Sponsor: Merck Healthcare KGaA (Pharmaceutical company). Phase: Therapeutic exploratory (Phase II). Countries: Italy (ended), France (ended), Belgium (ended), Germany (ended), Spain (ended).
Therapeutic area(s): Diseases [C] - Neoplasms [C04]
Gender: Female, Male. Age: 18-64 years, 65+ years. Enrolment: 16.
Status: Ended. Start date (EU): 2019-11-07. End date (EU): 2024-12-11. End date: 2026-07-15. Decision date: 2024-07-08. Results received: No. Last updated: 2024-09-06.
Decision dates by country: FR: 2024-07-10, DE: 2024-07-09, IT: 2024-07-10, ES: 2024-07-10, BE: 2024-07-08

Condition(s): Lung Cancer
Product: TAGRISSO 80 mg film-coated tablets, TAGRISSO 40 mg film-coated tablets, Tepotinib

Primary endpoint: Objective response (confirmed complete response [CR] or partial response [PR]) determined according to Response Evaluation Criteria in Solid Tumors (RECIST) Version 1.1 as per Independent Review Committee (IRC).
Endpoint(s): Objective response (CR or PR) determined according to RECIST Version 1.1 as per IRC., Occurrence of Adverse Events (AEs) and treatment related AEs. Occurrence of abnormalities (Grade ≥ 3) in laboratory test values (hematology and coagulation, biochemistry) and urinalysis. Occurrence of markedly abnormal vital sign measurements change in body weight, and Eastern Cooperative Oncology Group (ECOG) performance status. Occurrence of clinically significantly abnormal electrocardiograms (ECGs)., Occurrence of AEs and treatment related AEs. Occurrence of abnormalities (Grade ≥ 3) in laboratory test values (hematology and coagulation, biochemistry) and urinalysis. Occurrence of markedly abnormal vital sign measurements change in body weight, and ECOG performance status. Occurrence of clinically significantly abnormal ECGs., Objective response according to RECIST v1.1 assessed by the investigator. Confirmed CR assessed by the IRC and by the investigator. Duration of response assessed from CR or PR until disease progression, death, or last tumor assessment assessed by IRB and investigator. Disease control (CR+PR or confirmed SD lasting at least 12 weeks) as assessed by the CRI and by the investigator. PFS according to RECIST v1.1 by IRC and by Investigator. Overall survival., Patient reported outcomes/health related quality of life as reported using the following: EuroQol Five Dimension Five Level Scale. European Organisation for Research and Treatment of Cancer Quality of Life Questionnaire C30. NSCLC Symptom Assessment Questionnaire., Single and multiple dose PK profile of osimertinib, tepotinib, and their metabolites including but not limited to AUC0-t, Cmax, and tmax after first dose (Day 1) and after multiple study intervention dose administrations (Day 15). Population PK profile of osimertinib, tepotinib, and their metabolites, including, but not limited to, CL/f and VZ/f based on sparse PK sampling on Day 1, Cycle 1 and 2 (all study participants)., Mutation status in EGFR and other pathways assessed in circulating tumor deoxyribonucleic acid (ctDNA) at Baseline and progression (all study participants).

Source: https://euclinicaltrials.eu/ctis-public/view/2024-512005-87-00